EU clinical trial 2024-517528-20-00: A Randomized, Blinded, Placebo-Controlled, Phase 2 Study of INBRX-109 in Unresectable or Metastatic Conventional Chondrosarcoma
Protocol code: Ph2 INBRX-109 SA CS
Sponsor: Inhibrx Biosciences Inc. (Pharmaceutical company). Phase: Therapeutic exploratory (Phase II). Countries: France (ongoing, recruitment ended), Italy (ongoing, recruitment ended), Germany (ongoing, recruitment ended), Ireland (ongoing, recruitment ended), Netherlands (ongoing, recruitment ended), Spain (ongoing, recruitment ended).
Therapeutic area(s): Diseases [C] - Neoplasms [C04]
Gender: Female, Male. Age: 18-64 years, 65+ years. Enrolment: 97.
Status: Ongoing, recruitment ended. Start date (EU): 2022-04-19. Decision date: 2024-10-21. Results received: No. Last updated: 2026-07-03.
Decision dates by country: DE: 2024-10-29, IT: 2024-10-28, IE: 2024-10-25, NL: 2024-10-21, FR: 2024-10-25, ES: 2024-10-28

Condition(s): Unresectable or metastatic conventional chondrosarcoma
Product: DEXAMETHASONE, ACETYLCYSTEINE, DIPHENHYDRAMINE, GLUCOSE

Primary endpoint: Progression Free Survival (PFS) per RECISTv1.1 assessed by central IRR in the ITT population
Endpoint(s): Overall Survival (OS) in the ITT Population, ORR per RECISTv1.1 by central real-time IRR., PFS per RECISTv1.1 by Investigator assessment., QoL per EORTC QLQ-C30 (Pain and Physical Function)., DCR per RECISTv1.1 by central real-time IRR., DOR per RECISTv1.1 by central real-time IRR., Treatment emergent adverse events (TEAEs) including Serious adverse event (SAEs)., PK characterization: AUC0-inf, AUC0-last, AUC0-21d, Cmax, Ctrough, Tmax will be estimated using a standard non-compartmental method as the data allow. Other PK parameters (λz, t½, Vd, CL, and accumulation ratios RCmax, RCtrough) will be calculated if data permit., Frequency of ADAs and Nabs.

Source: https://euclinicaltrials.eu/ctis-public/view/2024-517528-20-00